EU clinical trial 2025-521878-33-00: Brimonidine eye drops in the prevention of myopia progression
Protocol code: BPM2024
Sponsor: Fundacion Para La Investigacion Biomedica Del Hospital Universitario Ramon Y Cajal (Laboratory/Research/Testing facility). Phase: Therapeutic exploratory (Phase II). Countries: Spain (ongoing, recruiting).
Therapeutic area(s): Phenomena and Processes [G] - Ocular Physiological Phenomena [G14]
Gender: Female, Male. Age: 0-17 years. Enrolment: 40.
Status: Ongoing, recruiting. Start date (EU): 2025-12-10. Decision date: 2025-07-18. Results received: No. Last updated: 2025-08-28.

Condition(s): Myopia
Product: Lumobry 0,25 mg/ml colirio en solución

Primary endpoint: Myopia progression (change in spherical equivalent of refractive error) measured every 6 months
Endpoint(s): Change in axial length of the eye; axial length to corneal radius ratio (related to type of refractive error or myopia classification and risk of progression), Visual acuity (logMAR scale) for distance and near vision, Stereo acuity by Randot circles / Randot preschool chart (initial visit only) in arc seconds (will be converted to logarithmic scale for statistical use of the variable)., Pupillometry/accommodation (Power Refractor III) Pupillometry in mm, under scotopic (< 1 cd/m2), mesopic (2-3 cd/m2) and photopic (10-20 cd/m2) conditions, using Power Refractor 3, Corneal topography with Oculus Pentacam elevation topographer., Accommodation (amplitude of accommodation in diopters and accommodative gain resulting from the ratio of accommodation required/accommodation achieved or realized) with Power Refractor 3, Intraocular pressure with air tonometer (non-contact) Tonoref III (Nidek), unless it is necessary to use the applanation tonometer, in inconclusive cases; measured in mm Hg-., Safety: collection of adverse events

Source: https://euclinicaltrials.eu/ctis-public/view/2025-521878-33-00